EU clinical trial 2025-523432-39-01: A Phase 1/2, Open-label Study of VS-7375, a KRAS G12D (ON/OFF) Inhibitor, as Monotherapy and in Combination, in Patients with Advanced KRAS G12D-Mutant Solid Tumors
Protocol code: VS-7375-101
Sponsor: Verastem Inc. (Pharmaceutical company). Phase: Phase I and Phase II (Integrated)- Other. Countries: Italy (authorised, recruitment pending), France (authorised, recruitment pending), Germany (authorised, recruitment pending), Belgium (authorised, recruitment pending), Spain (authorised, recruitment pending), Netherlands (authorised, recruitment pending).
Therapeutic area(s): Diseases [C] - Neoplasms [C04]
Gender: Female, Male. Age: 18-64 years, 65+ years. Enrolment: 210.
Status: Authorised, recruitment pending. Decision date: 2026-06-09. Results received: No. Last updated: 2026-08-07.
Decision dates by country: ES: 2026-06-12, DE: 2026-06-09, IT: 2026-06-10, FR: 2026-06-09, BE: 2026-06-09, NL: 2026-06-15

Condition(s): Advanced KRAS G12D-Mutant Solid Tumors
Product: Carboplatin Hikma 10 mg/ml Konzentrat zur Herstellung einer Infusionslösung, Pemetrexed STADA 25 mg/ml Konzentrat zur Herstellung einer Infusionslösung, Ribozar 1 g Pulver zur Herstellung einer Infusionslösung, VS-7375/GFH375, Erbitux 5 mg/mL solution for infusion, PEMETREXED VIATRIS 25 mg/ml, solution à diluer pour perfusion, Abraxane 5 mg/ml powder for dispersion for infusion., KEYTRUDA 25 mg/mL concentrate for solution for infusion.

Primary endpoint: Proportion/number of participants with AEs, TEAEs, TRAEs, SAEs, and DLTs; and abnormal vital signs, physical examination, ECG parameters, ECOG PS, clinical laboratory results; and dose interruptions/reductions., Proportion/number of participants with DLTs during the DLT assessment period (C1D1 through C1D21)., Confirmed ORR by blinded independent central review (BICR) per RECIST v1.1., Proportion/number of participants with AEs, TEAEs, TRAEs, SAEs, and DLTs; and abnormal vital signs, physical examination, ECG parameters, ECOG PS, clinical laboratory results; and dose interruptions/reductions., Proportion/number of participants with DLTs during the DLT assessment period (through C1)., Confirmed ORRby BICR, per RECIST v1.1., AUC0-t, AUC0-inf, and Cmax of midazolam, repaglinide and relative metabolites., Proportion/number of participants with AEs, TEAEs, TRAEs, SAEs; and abnormal vital signs, physical examination, ECG parameters, ECOG PS, clinical laboratory results; and dose interruptions/reductions.
Endpoint(s): PK parameters derived from plasma concentrations of VS-7375 including Cmax and AUC., Confirmed ORR, DCR, and DOR per RECIST v1.1. Unless otherwise specified, all tumor response-based endpoints will be analyzed using both BICR and Investigator assessments., Confirmed ORR by Investigator-assessed DOR, BoR, DCR, PFS per RECIST 1.1 and OS., Proportion/number of participants with AEs, TEAEs, TRAEs, SAEs, and abnormal vital signs, physical examination, ECG parameters, ECOG PS, clinical laboratory results; and dose interruptions/reductions., PK parameters derived from plasma concentrations of VS-7375 including Cmax and AUC, Change in nab-paclitaxel exposures in the presence and absence of VS-7375.

Source: https://euclinicaltrials.eu/ctis-public/view/2025-523432-39-01